EU clinical trial 2024-516505-23-00: Long-Term Open-Label Study to Assess the Safety and Efficacy of Vatiquinone in Patients With Friedreich Ataxia
Protocol code: PTC743-NEU-003e-FA
Sponsor: PTC Therapeutics Inc. (Pharmaceutical company). Phase: Therapeutic confirmatory (Phase III). Countries: Germany (ongoing, recruiting), France (ongoing, recruiting), Italy (ongoing, recruiting), Spain (ongoing, recruiting).
Therapeutic area(s): Diseases [C] - Nervous System Diseases [C10]
Gender: Female, Male. Age: 0-17 years, 18-64 years, 65+ years. Enrolment: 34.
Status: Ongoing, recruiting. Start date (EU): 2023-03-22. Decision date: 2024-10-24. Results received: No. Last updated: 2026-03-02.
Decision dates by country: ES: 2024-10-31, FR: 2024-10-25, IT: 2024-11-25, DE: 2024-10-24

Condition(s): Friedreich ataxia
Product: Vatiquinone

Primary endpoint: Adverse events (AEs)/serious adverse events (SAEs), laboratory abnormalities, vital signs, and electrocardiograms (ECGs)
Endpoint(s): Change from baseline in the mFARS and its 4 subscales (Upright Stability, Upper Limb, Lower Limb, Bulbar)

Source: https://euclinicaltrials.eu/ctis-public/view/2024-516505-23-00